EU clinical trial 2023-503317-29-00: CARE1: FIRST LINE RANDOMISED STUDY PLATFORM TO OPTIMIZE TREATMENT IN PATIENTS WITH METASTATIC RENAL CELL CARCINOMA
Protocol code: 2023/3764
Sponsor: Institut Gustave Roussy (Hospital/Clinic/Other health care facility). Phase: Therapeutic confirmatory (Phase III). Countries: France (ongoing, recruiting), Czechia (ongoing, recruiting), Netherlands (ongoing, recruiting), Austria (ongoing, recruiting), Italy (ongoing, recruiting), Finland (ongoing, recruiting), Germany (ongoing, recruiting), Greece (authorised, recruiting), Denmark (authorised, recruitment pending), Belgium (ongoing, recruiting).
Therapeutic area(s): Not possible to specify
Gender: Female, Male. Age: 18-64 years, 65+ years. Enrolment: 1073.
Start date (EU): 2024-04-12. Decision date: 2024-04-02. Results received: No. Last updated: 2026-06-01.
Decision dates by country: NL: 2024-11-22, AT: 2024-11-25, FI: 2025-06-26, CZ: 2024-07-22, GR: 2026-01-19, DK: 2026-02-05, BE: 2026-03-17, IT: 2025-05-13, DE: 2025-12-16, FR: 2024-04-02

Condition(s): Metastatic renal cell carcinoma (mRCC)
Product: YERVOY 5 mg/ml concentrate for solution for infusion, CABOMETYX 40 mg film-coated tablets, OPDIVO 10 mg/mL concentrate for solution for infusion., KEYTRUDA 25 mg/mL concentrate for solution for infusion, LENVIMA 10 mg hard capsules, OPDIVO 10 mg/mL concentrate for solution for infusion., AXITINIB SANDOZ 5 mg, comprimé pelliculé

Primary endpoint: Overall Survival (OS), Progression-free survival according to RECIST 1.1 NB: Progression-free survival is a co-primary endpoint in the PDL1(-) population, Objective Response Rate (ORR) according to RECIST 1.1, Percentage of patients experiencing a deterioration of ≥3 points on the NFKSI-19 scorein the first twelve months after randomization; Mean Change from Baseline in EQ-VAS andResponse frequencies for the EQ-5D-5L dimensions, Median treatment duration (per treatment), Time to subsequent systemic therapy, defined as the time from the date ofrandomisation to the date of next subsequent systemic therapy. In absence of subsequenttherapy, the data will be censored at the date of last follow-up; Patients dying without receivinga subsequent treatment will be censored at the date of death., Percentage of subjects experiencing grade 3-5 AEs, percentage of patientsexperiencing treatment-related grade 3-5 AEs, Percentage of patients experiencing AE grade≥2leading to the modification of administration of a study drug, Health economic evaluation through the incremental cost per Quality-adjusted life year(QALY), incremental net monetary benefit in the two patient subgroups (PDL1(+) and PDL1(-)respectively)

Source: https://euclinicaltrials.eu/ctis-public/view/2023-503317-29-00